EU clinical trial 2024-515202-84-00: A Phase 2/3, Double-Blind, Randomized, Placebo-Controlled, Multicenter Study to Evaluate the Efficacy and Safety of Mitapivat in Subjects With Sickle Cell Disease.
Protocol code: AG348-C-020
Sponsor: Agios Pharmaceuticals Inc. (Pharmaceutical company). Phase: Phase II and Phase III (Integrated). Countries: Netherlands (ongoing, recruitment ended), Germany (ongoing, recruitment ended), Belgium (ongoing, recruitment ended), France (ongoing, recruitment ended), Italy (ongoing, recruitment ended).
Therapeutic area(s): Diseases [C] - Hemic and Lymphatic Diseases [C15]
Gender: Female, Male. Age: 0-17 years, 18-64 years, 65+ years. Enrolment: 66.
Status: Ongoing, recruitment ended. Start date (EU): 2024-08-30. Decision date: 2024-08-13. Results received: No. Last updated: 2026-01-26.
Decision dates by country: BE: 2024-08-19, NL: 2024-08-13, DE: 2024-08-14, IT: 2024-09-02, FR: 2024-08-26

Condition(s): Anemia in subjects with sickle cell disease (SCD)
Product: MITAPIVAT, MITAPIVAT, "Placebo to Match Mitapivat Tablets, 5 mg and 20 mg, are supplied as film-coated, blue, round tablets for oral administration Placebo to Match Mitapivat Tablets, 50 mg or 100 mg, are supplied as film-coated, blue, oblong tablets for oral administration. Placebo to Match Mitapivat Granules, 1 mg, are supplied as film-coated, white, round granules for oral administration", MITAPIVAT

Primary endpoint: Hemoglobin (Hb) response, defined as a ≥1.0 g/dL increase in average Hb concentration from Week 24 through Week 52 compared with baseline, Annualized rate of SCPCs (as defined in Section 8.5.2.1)
Endpoint(s): Average change from baseline in Hb concentration from Week 24 through Week 52, Average change from baseline in indirect bilirubin from Week 24 through Week 52, Average change from baseline in percent reticulocyte from Week 24 through Week 52, Average change from baseline in Patient-Reported Outcomes Measurement Information System®(PROMIS) Fatigue 13a Short Form (SF) scores from Week 24 through Week 52, Annualized frequency of hospitalizations for SCPC

Source: https://euclinicaltrials.eu/ctis-public/view/2024-515202-84-00